EU clinical trial 2023-503254-12-00: A Phase 3 Randomized, Placebo-controlled, Double-blind Study of Niraparib in Combination with Abiraterone Acetate and Prednisone Versus Abiraterone Acetate and Prednisone for Treatment of Subjects with Metastatic Prostate Cancer
Protocol code: 64091742PCR3001
Sponsor: Janssen - Cilag International (Pharmaceutical company). Phase: Therapeutic confirmatory (Phase III). Countries: Poland (ongoing, recruitment ended), Spain (ongoing, recruitment ended), Portugal (ongoing, recruitment ended), Czechia (ongoing, recruitment ended), Hungary (ongoing, recruitment ended), Germany (ended), Sweden (ended), Italy (ongoing, recruitment ended), France (ongoing, recruitment ended), Belgium (ended).
Therapeutic area(s): Diseases [C] - Neoplasms [C04]
Gender: Male. Age: 18-64 years, 65+ years. Enrolment: 235.
Start date (EU): 2019-03-06. Decision date: 2024-04-03. Results received: No. Last updated: 2025-12-09.
Decision dates by country: SE: 2024-04-04, ES: 2024-04-04, FR: 2024-04-03, DE: 2024-04-12, CZ: 2024-04-04, IT: 2024-04-04, BE: 2024-04-09, PL: 2024-04-04, HU: 2024-04-04, PT: 2024-04-03

Condition(s): Metastatic Prostate Cancer
Product: ABIRATERONE, DEGARELIX, Niraparib - capsule - 100 mg, RELUGOLIX, Niraparib tosylate monohydrate+ abiraterone acetate - Film coated tablet- 159.40 mg (eq. 100mg base)+ 500mg, Placebo for Niraparib, Prednison acis 5 mg, Tabletten, Niraparib tosylate monohydrate + abiraterone acetate - Film coated tablet- 79.90 mg (eq. 50mg base)+ 500mg, TECHNETIUM (99MTC) COMPOUNDS, Abiraterone acetate - tablet - 250 mg

Primary endpoint: Radiographic progression-free survival (rPFS)

Source: https://euclinicaltrials.eu/ctis-public/view/2023-503254-12-00